EU clinical trial 2024-516741-39-00: MOdern Treatment of Inhibitor-PositiVe PATiEnts with Haemophilia A – An International Low-Interventional Pragmatic Investigator Initiated Trial
Protocol code: MOTIVATE
Sponsor: HZRM Haemophilie-Zentrum Rhein Main GmbH, Emory University (Hospital/Clinic/Other health care facility, Educational Institution). Phase: Therapeutic use (Phase IV). Countries: Finland (ended), Croatia (ongoing, recruiting), Norway (ongoing, recruiting), Germany (ongoing, recruiting), Sweden (ongoing, recruiting), Spain (ongoing, recruiting), Bulgaria (ended).
Therapeutic area(s): Diseases [C] - Hemic and Lymphatic Diseases [C15]
Gender: Male. Age: 0-17 years, 18-64 years, 65+ years. Enrolment: 22.
Start date (EU): 2020-01-14. Decision date: 2024-08-27. Results received: No. Last updated: 2025-10-28.
Decision dates by country: DE: 2024-08-30, NO: 2024-09-02, SE: 2024-08-28, FI: 2024-08-27, HR: 2024-09-02, ES: 2024-08-30, BG: 2025-10-28

Condition(s): Haemophilia A
Product: Nuwiq 2500 IU powder and solvent for solution for injection, NovoSeven 5 mg (250 KIU) powder and solvent for solution for injection, OCTANATE 1000 Pulver und Lösungsmittel zur Herstellung einer Injektionslösung, FEIBA 1000 E Pulver und Lösungsmittel zur Herstellung einer Infusionslösung, Wilate 1000, 1000 I.E. VWF/1000 I.E. FVIII, Pulver und Lösungsmittel zur Herstellung einer intravenösen Injektionslösung., Nuwiq 1500 IU powder and solvent for solution for injection, Hemlibra 150 mg/mL solution for injection, CEVENFACTA 1 mg (45 KIU) powder and solvent for solution for injection, Hemlibra 150 mg/mL solution for injection, NovoSeven 8 mg (400 KIU) powder and solvent for solution for injection, Nuwiq 500 IU powder and solvent for solution for injection, CEVENFACTA 5 mg (225 KIU) powder and solvent for solution for injection, OCTANATE 500 Pulver und Lösungsmittel zur Herstellung einer Injektionslösung, Hemlibra 30 mg/mL solution for injection, Hemlibra 30 mg/mL solution for injection, Hemlibra 150 mg/mL solution for injection, NovoSeven 2 mg (100 KIU) powder and solvent for solution for injection, Nuwiq 4000 IU powder and solvent for solution for injection, FEIBA 500 E Pulver und Lösungsmittel zur Herstellung einer Infusionslösung., OCTANATE 250 Pulver und Lösungsmittel zur Herstellung einer Injektionslösung, Nuwiq 3000 IU powder and solvent for solution for injection, CEVENFACTA 2 mg (90 KIU) powder and solvent for solution for injection, FEIBA 2500 E Pulver und Lösungsmittel zur Herstellung einer Infusionslösung., Nuwiq 1000 IU powder and solvent for solution for injection, Nuwiq 250 IU powder and solvent for solution for injection, Hemlibra 150 mg/mL solution for injection, Wilate 500, 500 I.E. VWF/500 I.E. FVIII, Pulver und Lösungsmittel zur Herstellung einer intravenösen Injektionslösung., Nuwiq 2000 IU powder and solvent for solution for injection, NovoSeven 1 mg (50 KIU) powder and solvent for solution for injection

Primary endpoint: The primary endpoint in Group 1 and Group 2 is to evaluate ITI outcome as determined by achievement of the following ITI criteria: 1. Inhibitor titre < 0.6 BU/mL for at least 2 consecutive measurements 2. FVIII recovery ≥ 66% of the predefined reference value of 1.5% IU/kg BW 3. FVIII half-life ≥ 6 h, The primary endpoint for Group 3 is to evaluate the ABR compared with the ABR in Group 1 and Group 2.
Endpoint(s): For participants in Group 1 and Group 2: 1. Time to achieve ITI outcome 2. Use of emicizumab, aPCC, rFVIIa during ITI 3. Rate of FVIII inhibitor relapses during a follow-up period in participants who have achieved complete ITI success, For participants in all 3 groups: 1. Frequency and severity of all bleeding episodes (BEs), all treated BEs, all spontaneous BEs, all joint BEs, and target joint BEs over time (≥ 3 bleeds in the same joint within 24 weeks) 2. Number of infusions required to control BEs 3. Frequency and severity of bleeding during and after surgical procedures, For participants in all 3 groups: 4. Proportion of participants experiencing ADRs 5. Thrombotic events (location, treatment, outcome) 6. Treatment costs

Source: https://euclinicaltrials.eu/ctis-public/view/2024-516741-39-00